EU clinical trial 2023-510261-94-00: Inhaled isoflurane for SEdation of invasively ventilated PaTIents with cardiogenic shock on extracOrporeal membrane oxygeNation (INSEPTION)
Protocol code: APHP230844
Sponsor: Assistance Publique Hopitaux De Paris (Hospital/Clinic/Other health care facility). Phase: Therapeutic confirmatory (Phase III). Countries: France (ongoing, recruiting).
Therapeutic area(s): Diseases [C] - Cardiovascular Diseases [C14]; Diseases [C] - Respiratory Tract Diseases [C08]
Gender: Female, Male. Age: 18-64 years, 65+ years. Enrolment: 300.
Status: Ongoing, recruiting. Start date (EU): 2026-04-26. Decision date: 2025-05-23. Results received: No. Last updated: 2026-03-04.

Condition(s): Adult patients with severe cardiogenic shock on venoarterial ECMO support for less than 24 hours.
Product: MIDAZOLAM, CEDACONDA 100 % V/V, liquide pour inhalation par vapeur, PROPOFOL

Primary endpoint: A composite outcome of mortality and number of days alive without invasive mechanical ventilation within 28 days following ECMO initiation (detail in protocol)
Endpoint(s): Overall survival within 28 days, Ventricular assist device or/and heart transplant on day 28, Number of ECMO-free days on day 14 and day 28, Number of inotropes-free days on day 14 and day 28, Number of ICU-free days on day 28, Number of ventilation-free days on day 14 and day 28, Delirium-free days (evaluated with Confusion Assessment Method for the ICU [CAM-ICU]) on day 14 and day 28, Daily morphine equivalent dose during mechanical ventilation until day 14, Daily propofol, and midazolam doses during mechanical ventilation until day 14, Daily propofol or midazolam bolus needed to achieve the prescribed sedation range until day 14, Daily neuroleptics need until day 14, Daily clonidine needs until day 14, Daily dexmedetomidine need until day 14, Rate of side effects possibly linked to ineffective sedation (self-extubation, accidental ECMO decannulation, catheter withdrawal, etc.), Incidence of drugs side effects (refractory hypertension, malignant hyperthermia), Primary and secondary endpoints in predefined subgroups: patients with pre-ECMO cardiac arrest, and patients with acute myocardial infarction.

Source: https://euclinicaltrials.eu/ctis-public/view/2023-510261-94-00